EU clinical trial 2024-512378-91-00: A Randomised, Open-Label, Phase 2 Study of Ceralasertib Monotherapy and Ceralasertib plus Durvalumab in Patients with Unresectable or Advanced Melanoma and Primary or Secondary Resistance to PD-(L)1 Inhibition
Protocol code: D533AC00001
Sponsor: AstraZeneca AB (Pharmaceutical company). Phase: Therapeutic exploratory (Phase II). Countries: Germany (ongoing, recruitment ended), Spain (ended), France (ended), Belgium (ended), Italy (ongoing, recruitment ended), Poland (ongoing, recruitment ended).
Therapeutic area(s): Diseases [C] - Neoplasms [C04]
Gender: Female, Male. Age: 18-64 years, 65+ years. Enrolment: 205.
Start date (EU): 2022-06-24. Decision date: 2024-08-07. Results received: No. Last updated: 2026-07-21.
Decision dates by country: BE: 2024-08-08, FR: 2024-08-07, ES: 2024-08-12, IT: 2024-08-20, PL: 2024-08-08, DE: 2024-08-09

Condition(s): Unresectable or Advanced Melanoma
Product: Mycophenolate Mofetil 250 mg Capsules, IMFINZI 50 mg/mL concentrate for solution for infusion., Inflectra 100 mg powder for concentrate for solution for infusion, Ceralasertib

Primary endpoint: The primary measure is the estimate of ORR for each experimental treatment arm, and a secondary measure of interest is the odds ratio of the ORR comparing the 2 treatment arms., Biopsy Sub-study: CD8+ T cells tumour infiltration assessed in baseline, on-treatment and off-treatment tumour biopsies.
Endpoint(s): Median and landmark DoR estimates at 6, 9, 12, 15, and 18 months, Median TTR and proportion of patients with response at the first scheduled tumour assessment, Percentage change from baseline in TL tumour size at week 16 and best percentage change from baseline, Median and landmark PFS at 3, 6, 9, 12 months, and the hazard ratio comparing the 2 treatment arms, Median and landmark OS at 6, 9, 12, and 18 months, and the hazard ratio comparing the 2 treatment arms, Concentration of ceralasertib in plasma (peak and trough concentrations, as data allow; sparse sampling), Biopsy Sub-study: As described for the main study, using the investigator assessment of tumour response per RECIST 1.1, Biopsy Sub-study: Pre-treatment presence and/or on-treatment and/or off-treatment changes in PD-L1 and pRAD50, Biopsy Sub-study: Proliferation (using Ki67+ marker) of carcinoma and/or immune cells (including CD8+ T cells) will be assessed in baseline, on-treatment and off-treatment tumour biopsies

Source: https://euclinicaltrials.eu/ctis-public/view/2024-512378-91-00